EU clinical trial 2024-513433-20-00: A Phase II randomized Study to evaluate the efficacy and safety of Cisplatin or Carboplatin / Etoposide and concomitant Radiotherapy combined with Durvalumab followed by Maintenance Therapy with Durvalumab versus Cisplatin or Carboplatin / Etoposide and concomitant Radiotherapy in Patients with limited disease Small Cell Lung Cancer.
Sponsor: Universitaetsmedizin der Johannes Gutenberg-Universitaet Mainz KöR (Hospital/Clinic/Other health care facility). Phase: Therapeutic exploratory (Phase II). Countries: Germany (ongoing, recruitment ended).
Therapeutic area(s): Diseases [C] - Neoplasms [C04]
Gender: Female, Male. Age: 18-64 years, 65+ years. Enrolment: 105.
Status: Ongoing, recruitment ended. Start date (EU): 2020-12-16. Decision date: 2024-09-03. Results received: No. Last updated: 2026-08-07.

Condition(s): Limited Disease Small Cell Lung Cancer
Product: IMFINZI 50 mg/mL concentrate for solution for infusion., CISPLATIN, ETOPOSIDE, CARBOPLATIN

Primary endpoint: Progression-free survival (PFS) after 18 months according to RECIST1.1 as well as iRECIST for Durvalumab group only
Endpoint(s): Progression-free survival (PSF) after other assessments, Overall survival (OS), Overall response rate (ORR), Disease control rate (DCR), Safety and Tolerability, Symptom control assessed by patient-reported quality of life (QoL) with QLQ-C30, QLQ-LC13 and EQ-5D

Source: https://euclinicaltrials.eu/ctis-public/view/2024-513433-20-00